EU clinical trial 2024-514176-41-00: A Phase 1b Study of JNJ-80948543 in Combination with Other CD3 TCEs for R/R B-cell NHL
Protocol code: 80948543LYM1002
Sponsor: Janssen Cilag International (Pharmaceutical company). Phase: Human Pharmacology (Phase I)- Other. Countries: Spain (ended).
Therapeutic area(s): Diseases [C] - Neoplasms [C04]
Gender: Female, Male. Age: 18-64 years, 65+ years. Enrolment: 16.
Status: Ended. Start date (EU): 2024-12-16. End date (EU): 2026-07-13. Decision date: 2024-10-31. Results received: No. Last updated: 2026-01-13.

Condition(s): Relapsed/Refractory B-cell Non-Hodgkin Lymphoid Malignancies

Source: https://euclinicaltrials.eu/ctis-public/view/2024-514176-41-00